EU clinical trial 2024-511408-18-00: A phase 3, randomised, double-blind, placebo-controlled study assessing the efficacy and safety of gliclazide MR in patients with type 2 diabetes inadequately controlled with dapagliflozin with or without metformin.
Protocol code: S005201-175
Sponsor: Institut De Recherches Internationales Servier IRIS (Pharmaceutical company). Phase: Therapeutic confirmatory (Phase III). Countries: Bulgaria (ended), Lithuania (ended), Latvia (ended), Hungary (ended), Poland (ended).
Therapeutic area(s): Diseases [C] - Nutritional and Metabolic Diseases [C18]
Gender: Female, Male. Age: 18-64 years, 65+ years. Enrolment: 242.
Status: Ended. Start date (EU): 2024-07-15. End date (EU): 2025-11-26. End date: 2025-12-09. Decision date: 2024-06-27. Results received: No. Last updated: 2025-10-13.
Decision dates by country: PL: 2024-07-01, HU: 2024-06-28, LV: 2024-06-28, BG: 2024-06-27, LT: 2024-06-27

Condition(s): Type 2 Diabetes inadequately controlled with dapagliflozin with or without metformin
Product: DIAMICRON 60MG, comprimé sécable à libération modifiée, Placebo S05762, METFORMIN, Forxiga 10 mg film-coated tablets

Primary endpoint: Change from baseline to week 24 in HbA1c.
Endpoint(s): Change from baseline to week 24 in centralised fasting plasma glucose (FPG), Proportion of participants at week 24 with: • HbA1c < 7.0% • HbA1c ≤ 6.5% • HbA1c < 7% without clinically important and/or severe hypoglycaemia, Proportion of participants requiring rescue therapy over 24 weeks, Adverse events, including hypoglycaemic events, genital infections, and urinary tract infections (UTIs), Vital signs (SBP, DBP, HR), body weight and clinical laboratory measures (biochemistry and haematology)

Source: https://euclinicaltrials.eu/ctis-public/view/2024-511408-18-00